EU clinical trial 2023-505640-18-00: A Phase 4 Study of Nusinersen (BIIB058) Among Patients With Spinal Muscular Atrophy Who Received Onasemnogene Abeparvovec - RESPOND
Protocol code: 232SM404
Sponsor: Biogen Idec Research Limited (Pharmaceutical company). Phase: Therapeutic use (Phase IV). Countries: Spain (ended), Germany (ended), Italy (ended).
Therapeutic area(s): Diseases [C] - Musculoskeletal Diseases [C05]
Gender: Female, Male. Age: 0-17 years. Enrolment: 25.
Status: Ended. Start date (EU): 2021-09-02. End date (EU): 2025-10-09. End date: 2025-10-09. Decision date: 2024-07-01. Results received: Yes. Last updated: 2025-10-02.
Decision dates by country: ES: 2024-07-01, DE: 2024-07-02, IT: 2024-07-09

Condition(s): Spinal Muscular Atrophy
Product: Spinraza 12 mg solution for injection

Primary endpoint: Total Hammersmith Infant Neurological Examination (HINE) Section 2 Motor Milestones Score [ Time Frame: Up to Day 778 ]
Endpoint(s): Number of Participants with Adverse Events (AEs) and Serious Adverse Events (SAEs) [ Time Frame: Up to Day 778 ], Number of Participants with Change from Baseline in Clinical Laboratory Parameters [ Time Frame: Up to Day 778 ], Number of Participants with Change from Baseline in Electrocardiograms (ECGs) [ Time Frame: Up to Day 778 ], Number of Participants with Change from Baseline in Vital Signs [ Time Frame: Up to Day 778 ], Number of Participants who Achieved Motor Milestones as Assessed by World Health Organization (WHO) Criteria [ Time Frame: Up to Day 778 ], Change from Baseline in Children's Hospital of Philadelphia Infant Test of Neuromuscular Disorders (CHOP INTEND) Score [ Time Frame: Up to Day 778 ], Change from Baseline in Hammersmith Functional Motor Scale - Expanded (HFMSE) Score [ Time Frame: Up to Day 778 ], Change from Baseline in Revised Upper Limb Module (RULM) Score [ Time Frame: Up to Day 778 ], Time to Death or Permanent Ventilation [ Time Frame: Up to Day 778 ], Change From Baseline in Cerebrospinal Fluid (CSF) Levels of Neurofilament Light Subunit (NF-L) [ Time Frame: Up to Day 659 ], Change From Baseline in Plasma Levels of NF-L [ Time Frame: Up to Day 778 ]

Source: https://euclinicaltrials.eu/ctis-public/view/2023-505640-18-00